EU clinical trial 2025-523896-44-00: Efanesoctocog alfa treatment in patients with synovitis in congenital hemophilia A: multicenter, randomized, open-label, phase 3 clinical trial
Protocol code: EfaSyn (ID16438)
Sponsor: GWT-Tud GmbH (Pharmaceutical company). Phase: Therapeutic confirmatory (Phase III). Countries: Austria (authorised, recruitment pending), Germany (authorised, recruitment pending).
Therapeutic area(s): Diseases [C] - Hemic and Lymphatic Diseases [C15]
Gender: Male. Age: 18-64 years, 65+ years. Enrolment: 60.
Status: Authorised, recruitment pending. Decision date: 2026-06-08. Results received: No. Last updated: 2026-06-10.
Decision dates by country: AT: 2026-06-08, DE: 2026-06-10

Condition(s): Congenital hemophilia A (HA), Synovitis
Product: ALTUVOCT 3 000 IU powder and solvent for solution for injection, ALTUVOCT 2 000 IU powder and solvent for solution for injection, ALTUVOCT 250 IU powder and solvent for solution for injection, ALTUVOCT 500 IU powder and solvent for solution for injection, ALTUVOCT 1 000 IU powder and solvent for solution for injection

Primary endpoint: Proportion of patients with treatment response (TR) after 12 months. TR is defined as a reduction or resolution of synovial hypertrophy in at least one affected joint according to the synovial hypertrophy domain of the Hemophilia Early Arthropathy Detection with Ultrasound (HEAD-US) score performed by blinded ultrasound expert (BLUE) team
Endpoint(s): related to pharmacokinetics and efficacy for bleed prevention of ERT: ■ FVIII trough level ■ Time spent at FVIII activity >30 IU/dL ■ Time spent at FVIII activity >50 IU/dL ■ Annualized bleeding rate (ABR, all treated bleeds) and annualized joint bleeding rate (AjBR, treated joint bleeds only), related to assessments and clinical relevance of synovitis: ■ Proportion of joints with TR ■ Proportion of patients with complete resolution of synovitis in all of their joints, related to safety of efanesoctocog alfa: ■ Treatment-emergent adverse events (TEAE)

Source: https://euclinicaltrials.eu/ctis-public/view/2025-523896-44-00